EU clinical trial 2023-507143-11-00: A Phase 3 Randomized, Multicenter Study of Subcutaneous Daratumumab Versus Active Monitoring in Subjects with High-risk Smoldering Multiple Myeloma
Protocol code: 54767414SMM3001
Sponsor: Janssen - Cilag International (Pharmaceutical company). Phase: Therapeutic confirmatory (Phase III). Countries: Denmark (ended), Sweden (ended), Czechia (ended), Belgium (ended), Hungary (ended), Spain (ended), Netherlands (ended), France (ended), Norway (ended), Italy (ended), Germany (ended), Poland (ended), Greece (ended).
Therapeutic area(s): Diseases [C] - Neoplasms [C04]
Gender: Female, Male. Age: 18-64 years, 65+ years. Enrolment: 144.
Status: Ended. Start date (EU): 2017-11-08. End date (EU): 2026-05-04. End date: 2026-05-05. Decision date: 2023-11-16. Results received: No. Last updated: 2026-05-11.
Decision dates by country: DE: 2023-11-21, SE: 2023-11-16, NL: 2023-11-21, NO: 2023-11-21, DK: 2023-11-16, PL: 2023-12-07, CZ: 2023-11-20, BE: 2023-11-16, ES: 2023-11-21, GR: 2024-02-05, FR: 2023-11-24, IT: 2023-12-05, HU: 2023-11-17

Condition(s): Precancerous form of blood cancer in the bone marrow
Product: JNJ-54767414

Primary endpoint: Progression-free survival (PFS), defined as the time from the date of randomization to the date of initial documented progression to MM according to the international myeloma working group (IMWG) diagnostic criteria for MM or the date of death, whichever occurs first

Source: https://euclinicaltrials.eu/ctis-public/view/2023-507143-11-00